EU clinical trial 2024-520354-37-00: Phase 2b, multicenter, randomized, double-blind, placebo-controlled study to evaluate the efficacy, immunogenicity and safety of one dose of OVX836 influenza vaccine 480μg, after intramuscular administration in healthy subjects aged 18-59 years
Protocol code: OVX836-005
Sponsor: Osivax (Pharmaceutical company). Phase: Therapeutic exploratory (Phase II). Countries: France (ended), Finland (ended), Belgium (ended), Germany (ended).
Therapeutic area(s): Diseases [C] - Virus Diseases [C02]
Gender: Female, Male. Age: 18-64 years. Enrolment: 2850.
Status: Ended. Start date (EU): 2025-09-08. End date (EU): 2026-05-18. Decision date: 2025-06-04. Results received: No. Last updated: 2026-05-15.
Decision dates by country: DE: 2025-06-23, FI: 2025-06-04, FR: 2025-06-10, BE: 2025-06-13

Condition(s): Influenza disease
Product: CHLORURE DE SODIUM 0,9 % B. BRAUN, solution pour perfusion, OVX836

Primary endpoint: First occurrence of RT-PCR-confirmed influenza Type A illness, from 14 days after vaccination, characterized by the presence of one or more of the following respiratory symptoms (sore throat, cough, sputum production, wheezing, difficulty breathing), concurrent with one or more of the following systemic symptoms (temperature ≥37.5°C, chills, tiredness, headache or myalgia), lasting for at least 24 hours.
Endpoint(s): First occurrence of laboratory-confirmed (RT-PCR-confirmed cases and in RT-PCR + culture-confirmed cases) influenza Type A symptomatic illness, from 14 days after vaccination, corresponding to other clinical definitions of the ILI (e.g., Centers for Disease Control and Prevention’s [CDC] definition [modified or not])., Subtype of virus in laboratory-confirmed (RT-PCR-confirmed cases and in RT-PCR + culture-confirmed cases) influenza Type A cases, from 14 days after vaccination., First occurrence of laboratory-confirmed (RT-PCR-confirmed cases and in RT-PCR + culture-confirmed cases) influenza symptomatic disease irrespective of strain/type, from 14 days after vaccination., First occurrence of laboratory-confirmed (RT-PCR-confirmed cases and in RT-PCR + culture-confirmed cases) influenza Type B symptomatic disease, from 14 days after vaccination., First occurrence of any ILIs irrespective of causal agent (confirmed or not by laboratory [RT-PCR-confirmed cases and in RT-PCR + culture-confirmed cases]), from 14 days after vaccination., Severity (mean and maximum grading of symptoms) and duration of ILI episodes, with a trapezoidal calculation of the area under the curve [AUC] of the daily scores on the Flu-PRO® questionnaire, by treatment group (OVX836 and placebo)., SF-12 HRQoL physical and mental components scores changes between baseline (Day 1) and 14 days after each ILI episode start date, by treatment group (OVX836 and placebo)., Mean and maximum EQ-5D-5L HRQoL scores and trapezoidal calculation of the AUC of the daily scores, by treatment group (OVX836 and placebo)., Mean and maximum EQ-5D-L HRQoL visual analog scale (VAS) score and trapezoidal calculation of the AUC of the daily scores, by treatment group (OVX836 and placebo)., Composite endpoint taking into account Flu-PRO® AUC, SF-12 change versus baseline and EQ-5D AUCs., Occurrence of solicited local and systemic signs and symptoms during 7 days after vaccine administration, Occurrence of unsolicited AEs during 29 days after vaccine administration., Occurrence of SAEs/AESI/NOCD/MAAEs during the whole study period., CMI response to OVX836 (480μg) in terms of NP-specific T-cell (number of spot-forming cells [SFC] per million PBMCs), measured by IFNγ ELISPOT, at Day 1 and Day 8, in a limited subset of 56 subjects (28 placebo and 28 OVX836 recipients)., Percentage of NP specific CD4+ and CD8+ T-cell measured by flow cytometry on PBMCs as expressing cytokines, e.g. IFNγ, IL-2 and TNFα, at pre-injection baseline (Day 1) and at Day 8, in a limited subset of 56 subjects (28 placebo and 28 OVX836 recipients), Anti-NP IgG measured by Enzyme Linked Immunosorbent Assay (ELISA) at pre-injection baseline (Day 1) and at Day 8, in a limited subset of 56 subjects (28 placebo and 28 OVX836 recipients)., The analyses of the primary and secondary efficacy endpoints will be replicated irrespectively of the time between vaccination and cases occurrence

Source: https://euclinicaltrials.eu/ctis-public/view/2024-520354-37-00